EU clinical trial 2024-518841-12-00: NeoART – A phase Ib/II platform trial evaluating the safety and activity of neoadjuvant trastuzumab-deruxtecan containing combination therapies for HER2+, resectable esophagogastric adenocarcinoma
Protocol code: NeoART
Sponsor: Frankfurter Institut Fuer Klinische Krebsforschung IKF GmbH (Pharmaceutical company). Phase: Phase I and Phase II (Integrated)- Other. Countries: Germany (temporarily halted), Austria (temporarily halted).
Therapeutic area(s): Diseases [C] - Digestive System Diseases [C06]; Diseases [C] - Neoplasms [C04]
Gender: Female, Male. Age: 18-64 years, 65+ years. Enrolment: 39.
Status: Temporarily halted. Start date (EU): 2025-03-25. Decision date: 2025-01-31. Results received: No. Last updated: 2026-04-20.
Decision dates by country: AT: 2025-06-02, DE: 2025-01-31

Condition(s): HER2 positive resectable esophagogastric adenocarcinoma
Product: Oxaliplatin Kabi 5 mg/ml Konzentrat zur Herstellung einer Infusionslösung, Leucovorin 10 mg/ml Lösung zur Injektion/ Infusion, 5-FU medac 50 mg/ml, Injektionslösung, DS-8201a

Primary endpoint: Feasibility rate, defined as proportion of patients receiving the protocol treatment according to the planned schedule before surgery without occurrence of at least one dose-limiting toxicity (DLT)
Endpoint(s): Assessment of safety of the treatment as determined by the incidence, type, causality, frequency, timing and severity of adverse events using NCI CTCAE 5.0, Perioperative morbidity (Clavien-Dindo classification) and mortality, Pathological complete remission (pCR) rate by local assessment corresponding to the ypT0 ypN0 stage category, R0 resection rate

Source: https://euclinicaltrials.eu/ctis-public/view/2024-518841-12-00